EU clinical trial 2022-502879-32-00: GENEPID: A 44-weeks monocentric open study assessing the efficacy and safety of Deucravacitinib in adults with Inflammatory EPidermal GENodermatoses (epidermolysis bullosa simplex and inflammatory congenital ichthyoses)
Protocol code: 22-PP-20
Sponsor: Centre Hospitalier Universitaire De Nice (Hospital/Clinic/Other health care facility). Phase: Therapeutic exploratory (Phase II). Countries: France (ongoing, recruiting).
Therapeutic area(s): Diseases [C] - Skin and Connective Tissue Diseases [C17]
Gender: Female, Male. Age: 18-64 years, 65+ years. Enrolment: 10.
Status: Ongoing, recruiting. Start date (EU): 2024-01-30. Decision date: 2023-09-25. Results received: No. Last updated: 2025-10-17.

Condition(s): Inflammatory EPidermal GENodermatoses
Product: deucravacitinib

Primary endpoint: The aim of this study is to assess the efficacy of deucravacitinib in the treatment of patients with EBS-sev and inflammatory congenital ichthyosis
Endpoint(s): Safety of deucravacitinib treatment, Secondary efficacy and health outcomes measures : severity, itch, pain, quality of life, Compliance, Baseline and functional cytokine profile

Source: https://euclinicaltrials.eu/ctis-public/view/2022-502879-32-00